EU clinical trial 2023-505828-58-00: CA-4948-104: A Ph1 Study of Emavusertib in AML CR MRD+ Patients Currently Receiving Azacitidine and Venetoclax
Protocol code: CA-4948-104
Sponsor: Curis Inc. (Pharmaceutical company). Phase: Human Pharmacology (Phase I)- Other. Countries: Italy (ongoing, recruitment ended), Germany (ended), Spain (ended).
Therapeutic area(s): Diseases [C] - Neoplasms [C04]
Gender: Female, Male. Age: 18-64 years, 65+ years. Enrolment: 24.
Start date (EU): 2023-12-05. Decision date: 2023-10-20. Results received: No. Last updated: 2026-05-19.
Decision dates by country: ES: 2023-10-20, DE: 2023-10-25, IT: 2023-10-23

Condition(s): Acute Myeloid Leukemia

Source: https://euclinicaltrials.eu/ctis-public/view/2023-505828-58-00